EU clinical trial 2024-517199-39-00: A RANDOMIZED, PLACEBO-CONTROLLED, TRIPLE-BLIND CLINICAL TRIAL TO INVESTIGATE TREATMENT EFFECTS AND SAFETY OF GINKGO BILOBA EXTRACT EGB 761® IN PARTICIPANTS WITH COGNITIVE IMPAIRMENT ASSOCIATED WITH POST-COVID-19 SYNDROME
Protocol code: D.01.02.3.03
Sponsor: Dr. Willmar Schwabe GmbH & Co. KG (Pharmaceutical company). Phase: Therapeutic exploratory (Phase II). Countries: Spain (ended), Germany (ended), Poland (ended).
Therapeutic area(s): Diseases [C] - Nervous System Diseases [C10]; Diseases [C] - Virus Diseases [C02]
Gender: Female, Male. Age: 18-64 years, 65+ years. Enrolment: 400.
Status: Ended. Start date (EU): 2025-03-19. End date (EU): 2026-06-23. Decision date: 2025-01-24. Results received: No. Last updated: 2026-06-22.
Decision dates by country: PL: 2025-02-10, ES: 2025-01-27, DE: 2025-01-24

Condition(s): COGNITIVE IMPAIRMENT ASSOCIATED WITH POST-COVID-19 SYNDROME
Product: Film-coated, round, yellow tablet for oral use with no active substance, Tebonin konzent 240 mg

Primary endpoint: Change from baseline to Week 6 and Week 12 in the following test scores: • Digit span forward and backward test • Verbal fluency test • TMT (A + B) • CVLT • d2-R, Change from baseline to Week 6 and Week 12 in the following questionnaire scores: • GAD-7 test • PHQ-9 tes, Change from baseline to Week 6 and Week 12 in the 11-point box scale score for vertigo and tinnitus, Change from baseline to Week 6 and Week 12 in the following test/questionnaire scores: • CGI-S • PCFSS • MFIS • mPEM-DSQ • SBQ-LC test • CGI-I at Week 6 and Week 12, Number of patients with AEs, ADRs and SAEs

Source: https://euclinicaltrials.eu/ctis-public/view/2024-517199-39-00